EU clinical trial 2022-501811-14-00: [68Ga]Ga-PentixaFor positron emission tomography for improved risk and disease assessment in myeloma
Sponsor: University Of Antwerp (Educational Institution). Phase: Phase I and Phase II (Integrated)- Other. Countries: Netherlands (authorised, recruitment pending), Belgium (ongoing, recruiting).
Therapeutic area(s): Analytical, Diagnostic and Therapeutic Techniques and Equipment [E] - Diagnosis [E01]; Diseases [C] - Neoplasms [C04]
Gender: Female, Male. Age: 18-64 years, 65+ years. Enrolment: 90.
Start date (EU): 2024-09-20. Decision date: 2023-07-17. Results received: No. Last updated: 2025-10-09.
Decision dates by country: BE: 2023-07-17, NL: 2023-07-17

Condition(s): Multiple Myeloma
Product: [68Ga]Ga-PentixaFor

Primary endpoint: to make an evaluation of the proportion of false negative (FN) PET results for[68Ga]Ga-PentixaFor PET/AC-CT at baseline. Whereas a FN scan is defined as the absence of a focal lesion suspected for myeloma (higher than local background for [68Ga]Ga-PentixaFor) and/or the absence of diffuse bone marrow uptake in a patient with proven multiple myeloma according to the IMWG criteria
Endpoint(s): Comparison of the proportion of false negative (FN) PET results between 18F-FDG/LDCT and [68Ga]Ga-PentixaFor PET/AC-CT at baseline. Whereas a FN scan for both tracers is defined as the absence of a focal lesion suspected for myeloma (higher than local background for [68Ga]Ga-PentixaFor, and DS4 for 18F-FDG) and/or the absence of diffuse bone marrow uptake in a patient with proven multiple myeloma according to the IMWG criteria., Comparison of the (number of) lesions for both tracers: (1) Perform an inter-observer agreement analysis for image quality and lesions conspicuity and evaluate the applicability of Deauville score (DS) in [68Ga]Ga-PentixaFor PET scans. The readers will score global image quality, lesion conspicuity and diagnostic confidence., Comparison of the (number of) lesions for both tracers: (2) Lesion detection rate analysis on patient level and on organ level (lymph nodes, bone marrow and other extra-medullar disease) by calculating the difference in detection ratio of 18F-FDG PET/LDCT and [68Ga]Ga-PentixaFor PET/AC-CT, i.e. the differential detection ratio (DDR). This will be done based on a lesion detection rate analysis. The fraction of the lesions detected by one tracer is the detection Ratio (DR)., Comparison of the (number of) lesions for both tracers: (3) Semi-quantitative analysis of radiotracer uptake in lesions to quantify lesion intensity (maximum tracer uptake) and contrast (tumor to local background) for both tracers. Standardized uptake value (SUV) measurements will be performed: SUVmax for lesions and SUVmean for local background areas will be determined. Lesion uptake, in terms of SUVmax and tumor-to-background ratio (TBR), will be compared for both tracers., To quantify [68Ga]Ga-PentixaFor uptake based on dynamic PET studies and full kinetic modelling. To evaluate if simplified measures like SUV are a valid alternative for clinical practice or more complicated methods are required., Evaluation of the prognostic value of [68Ga]Ga-PentixaFor PET tracer in multiple myeloma patients. Is there a difference in clinical outcome based on PET positivity for [68Ga]Ga-PentixaFor tracer, PET positivity for 18F-FDG tracer or PET positivity for both tracers (PET positivity at baseline)?, Evaluation of different PET features (application of IMPeTUs, SUVmax, TBR, LDR, Radiomics) to be used for prognosis. Can these features be linked to a higher risk group (based on R-ISS and ISS risk classification). Will the use of a different PET tracer, [68Ga]Ga-PentixaFor vs 18F-FDG, have an impact on the patient’s classification in a risk group?, Sub-analysis pre and post therapy We will evaluate whether differences are visible pre and post therapy for the radiotracers. A comparison of the baseline PET scan with PET scans after therapy will be made. This will be done for both tracers. An evaluation of the applicability of the tracers for a post therapy scan will be made.

Source: https://euclinicaltrials.eu/ctis-public/view/2022-501811-14-00